EU clinical trial 2024-515300-39-00: PRODIGE 69 – FOLFIRINEC - FOLFIRINOX versus PLATINUM - ETOPOSIDE as first line chemotherapy for metastatic grade 3 poorly differentiated neuroendocrine carcinoma of gastro entero pancreatic and unknown primary associated with molecular profiling for therapeutic targets & predictive biomarkers identification
Protocol code: PRODIGE69
Sponsor: Centre Hospitalier Universitaire De Dijon (Hospital/Clinic/Other health care facility). Phase: Therapeutic exploratory (Phase II). Countries: France (ongoing, recruiting).
Therapeutic area(s): Diseases [C] - Neoplasms [C04]
Gender: Female, Male. Age: 18-64 years, 65+ years. Enrolment: 218.
Status: Ongoing, recruiting. Start date (EU): 2024-10-18. Decision date: 2024-10-18. Results received: No. Last updated: 2025-09-23.

Condition(s): METASTATIC GRADE 3 POORLY DIFFERENTIATED NEUROENDOCRINE CARCINOMA OF GASTRO ENTERO PANCREATIC AND UNKNOWN PRIMARY
Product: OXALIPLATINE HOSPIRA 5 mg/ml, solution à diluer pour perfusion, Irinotecan Kabi 20 mg/ml concentrate for solution for infusion , ETOPOSIDE TEVA 200 mg/10 ml, solution injectable pour perfusion, FLUOROURACILE TEVA 1000 mg/20 ml, solution à diluer pour perfusion, Cisplatine Teva 1 mg/ml concentraat voor oplossing voor infusie.

Primary endpoint: To compare the progression-free survival (PFS) with mFOLFIRINOX regimen versus platinum - etoposide regimen according to the investigator using RECIST v1.1 criteria.
Endpoint(s): PFS according to the centralized review (RECIST v1.1 criteria), Best objective response rate (ORR), Median overall survival (OS), Safety according to NCI CTC V4.0, Dose-reductions, Quality of life assessed by EORTC QLQ-C30 and EQ-5D-5L, To establish a molecular profile within 2 months after tumor sample submission for each patient enrolled in the study anmolecular tumor board report to the treating physician.d to provide a, Frequency of Rb loss in G3 NEC irrespective of the SC or LC subtype, Correlation of ORR, PFS and OS under both chemotherapy regimens with molecular alterations (Rb, TP53, MSH2…)

Source: https://euclinicaltrials.eu/ctis-public/view/2024-515300-39-00